EU clinical trial 2024-510797-25-00: A Phase 3 Open-Label Study of Safety, Pharmacokinetics and Activity of Weekly Subcutaneous Pegzilarginase in Subjects <24 months old with Arginase 1 Deficiency
Protocol code: CAEB1102-301A
Sponsor: Immedica Pharma AB (Pharmaceutical company). Phase: Therapeutic confirmatory (Phase III). Countries: Portugal (ended), Austria (ended).
Therapeutic area(s): Diseases [C] - Nutritional and Metabolic Diseases [C18]
Gender: Female, Male. Age: 0-17 years. Enrolment: 2.
Status: Ended. Start date (EU): 2024-12-18. End date (EU): 2025-05-21. End date: 2025-06-18. Decision date: 2024-12-11. Results received: Yes. Last updated: 2025-03-21.
Decision dates by country: AT: 2024-12-12, PT: 2024-12-11

Condition(s): Arginase 1 deficiency (ARG1-D)
Product: Loargys 5 mg/ml solution for injection/infusion

Primary endpoint: Change from baseline in plasma arginine after 12 weeks of pegzilarginase treatment
Endpoint(s): Safety assessments will include: a. adverse events (AEs), including hypersensitivity reactions (HSRs), injection site reactions (ISRs), and hyperammonaemic events; b. laboratory tests; c. vital signs, physical examinations, growth assessments, and electrocardiograms (ECGs), PK parameters evaluation including half-life (T½), time to maximum observed concentration (Tmax), maximum observed concentration (Cmax), area under the plasma drug concentration-time curve from time 0 to time t (AUC0-t), area under the plasma drug concentration-time curve from time 0 extrapolated to infinite time (AUC0-∞), extravascular clearance (CL/F), and apparent volume of distribution at steady state after non-intravenous administration (Vss/F), PD response evaluation including anti-drug antibodies (ADAs), levels of plasma arginine and ornithine, Changes in physical function after 12 weeks of pegzilarginase treatment as measured by Gross Motor Function Measure (GMFM)-66 Parts A through E, as age appropriate and feasible

Source: https://euclinicaltrials.eu/ctis-public/view/2024-510797-25-00